EU clinical trial 2024-515307-19-00: A Phase 1a/b Study Investigating the Safety, Tolerability, Pharmacokinetics, Pharmacodynamics, and Preliminary Antitumor Activity of PRMT5 Inhibitor BGB-58067 Alone and in Combination with Anticancer Agents in Patients With Advanced Solid Tumors
Sponsor: BeOne Medicines AG (Pharmaceutical company). Phase: Human Pharmacology (Phase I)- First administration to humans. Countries: Spain (ongoing, recruiting), France (ongoing, recruiting), Denmark (ongoing, recruiting).
Therapeutic area(s): Diseases [C] - Neoplasms [C04]
Gender: Female, Male. Age: 18-64 years, 65+ years. Enrolment: 79.
Status: Ongoing, recruiting. Start date (EU): 2025-03-24. Decision date: 2025-01-29. Results received: No. Last updated: 2026-07-10.
Decision dates by country: DK: 2025-07-18, ES: 2025-01-29, FR: 2025-02-12

Condition(s): Advanced, or metastatic solid tumors with methylthioadenosine phosphorylase (MTAP) homozygous deletion and/or lost MTAP protein expression

Source: https://euclinicaltrials.eu/ctis-public/view/2024-515307-19-00